EU clinical trial 2025-520642-29-00: Evaluation of the regenerative efficacy of Endoret® (PRGF-Plasm Rich in Growth Factors) on the ocular surface of glaucoma patients treated chronically with ocular hypotensive drugs, Evaluación de la eficacia regenerativa de Endoret® (PRGF-Plasma Rico en Factores de Crecimiento) en la superficie ocular de pacientes glaucomatosos tratados de forma crónica con fármacos hipotensores oculares
Sponsor: Fundacio Institut De Recerca De L'Hospital De La Santa Creu I Sant Pau (Hospital/Clinic/Other health care facility). Phase: Therapeutic exploratory (Phase II). Countries: Spain (authorised, recruitment pending).
Therapeutic area(s): Diseases [C] - Eye Diseases [C11]
Gender: Female, Male. Age: 18-64 years, 65+ years. Enrolment: 30.
Status: Authorised, recruitment pending. Decision date: 2025-01-29. Results received: No. Last updated: 2025-01-29.

Condition(s): glaucoma
Product: ENDORET-PRGF

Primary endpoint: Tear Osmolarity: It will be measured using the Tearlab® system (a painless collection of a 30-nanoliter tear sample using a microchip with immediate results). The difference in tear osmolarity between V0 and V2 will be evaluated. Tear osmolarity has been selected as the primary variable of the study because its increase (hyperosmolarity) has been shown to be the best standalone clinical sign for diagnosing ocular surface pathology.

Source: https://euclinicaltrials.eu/ctis-public/view/2025-520642-29-00